EU clinical trial 2024-518549-27-00: Efficacy of Reduced Gadolinium Dose in Contrast-Enhanced Breast MRI
Sponsor: Radboud universitair medisch centrum Stichting (Hospital/Clinic/Other health care facility). Phase: Phase III and phase IV (Integrated). Countries: Netherlands (ongoing, recruiting).
Therapeutic area(s): Diseases [C] - Neoplasms [C04]
Gender: Female. Age: 18-64 years. Enrolment: 100.
Status: Ongoing, recruiting. Start date (EU): 2025-08-14. Decision date: 2025-02-20. Results received: No. Last updated: 2025-02-20.

Condition(s): Breast Cancer
Product: DOTAREM 0,5 mmol/ml oplossing voor injectie in injectieflacons.

Primary endpoint: Qualitative Evaluation of image quality, Quantitative Evaluation of image quality
Endpoint(s): Diagnostic performance

Source: https://euclinicaltrials.eu/ctis-public/view/2024-518549-27-00